EU clinical trial 2024-514274-46-00: An Open-Label, Multicenter Follow-up Study to Collect Long-term Data on Participants from Multiple Avelumab (MSB0010718C) Clinical Studies
Protocol code: MS100070_0176
Sponsor: Merck KGaA (Pharmaceutical company). Phase: Therapeutic confirmatory (Phase III). Countries: Italy (ongoing, recruitment ended), Bulgaria (ended), Poland (ended), Romania (ongoing, recruitment ended), France (ended), Spain (ended), Hungary (ended).
Therapeutic area(s): Not possible to specify
Gender: Female, Male. Age: 18-64 years, 65+ years. Enrolment: 13.
Start date (EU): 2019-06-21. Decision date: 2024-10-21. Results received: No. Last updated: 2025-12-19.
Decision dates by country: ES: 2024-10-23, RO: 2024-10-25, HU: 2024-10-21, IT: 2024-10-23, BG: 2024-10-25, FR: 2024-10-23, PL: 2024-10-23

Condition(s): Solid Tumors
Product: Bavencio 20 mg/mL concentrate for solution for infusion

Primary endpoint: Occurrence of treatment-related non-serious treatment-emergent adverse events (TEAEs), all serious adverse events (SAEs), immune-related adverse events (irAEs), and infusion-related reactions according to the version of National Cancer Institute Common Technology Criteria for Adverse Events (NCI-CTCAE) used in the respective parent study.
Endpoint(s): Overall Survival, from baseline in parent study to date of death due to any cause., Progression Free Survival according to Response Evaluation Criteria in Solid Tumors version 1.1 (RECIST v1.1) by Investigator, from baseline in parent study until progressive disease (PD) or death due to any cause., Duration Response assessed from complete response (CR) or partial response (PR) until PD or death due to any cause.

Source: https://euclinicaltrials.eu/ctis-public/view/2024-514274-46-00